EU clinical trial 2022-502024-51-00: A pivotal, multicentre, randomised, open-label, parallel-group trial on contraceptive efficacy, safety and tolerability of LVDS (Levonorgestrel Vaginal Delivery System) during 9 cycles in comparison with Desogestrel tablets 0.075 mg.
Protocol code: LR-302
Sponsor: Chemo Research S.L. (Pharmaceutical company). Phase: Therapeutic confirmatory (Phase III). Countries: Hungary (ended), Poland (ended), Spain (ended), Czechia (ended), Germany (ended), Lithuania (ended), Slovakia (ended), Romania (ended).
Therapeutic area(s): Phenomena and Processes [G] - Reproductive and Urinary Physiological Phenomena [G08]
Gender: Female. Age: 18-64 years. Enrolment: 1356.
Status: Ended. Start date (EU): 2023-07-12. End date (EU): 2025-03-26. Decision date: 2023-07-12. Results received: Yes. Last updated: 2025-04-15.
Decision dates by country: LT: 2023-07-12, HU: 2023-07-17, CZ: 2023-07-12, PL: 2023-07-17, RO: 2023-07-17, DE: 2023-07-17, SK: 2023-07-17, ES: 2023-07-12

Condition(s): Prevention of pregnancy
Product: Desirett 75 Mikrogramm Filmtabletten, Levonorgestrel Vaginal Delivery System 75

Primary endpoint: Overall Pearl Index (PI) in non-breastfeeding women aged ≤ 35 years (at the time of trial enrolment).
Endpoint(s): [Secondary efficacy:] Overall PI in women aged ≤ 35 years and in women > 35 years (at the time of trial enrolment)., [Secondary efficacy:] PI after correction for back-up contraception and sexual activity (evaluable cycles)., [Secondary efficacy:] PI after correction for back-up contraception and sexual activity (evaluable cycles) in women aged ≤ 35 years and in women > 35 years (at the time of trial enrolment)., [Secondary efficacy:] PI for method failure., [Secondary efficacy:] PI for method failure in women aged ≤ 35 years and in women > 35 years (at the time of trial enrolment)., [Secondary efficacy:] Pregnancy ratio by life table analysis., [Secondary efficacy:] Pregnancy ratio by life table analysis in women aged ≤ 35 years and in women > 35 years (at the time of trial enrolment)., [Secondary safety and tolerability:] Adverse events (AEs)., [Secondary safety and tolerability:] Vital Signs., [Secondary safety and tolerability:] Physical examination., [Secondary safety and tolerability:] Gynaecological examination, incl. transvaginal ultrasound examination and cervical cytology., [Secondary safety and tolerability:] Mastodynia/mastalgia/dysmenorrhea., [Secondary safety and tolerability:] Proportion of subjects with bleeding during Cycles 2-9 (non-inferiority test, key secondary endpoint)., [Secondary safety and tolerability:] Proportion of subjects with bleeding / spotting in each cycle., [Secondary safety and tolerability:] Proportion of subjects with absence of bleeding., [Secondary safety and tolerability:] Proportion of subjects with prolonged bleeding., [Secondary safety and tolerability:] Number of days per cycle and reference period with bleeding and with spotting., [Secondary safety and tolerability:] Number of bleeding / spotting episodes per reference period., [Secondary safety and tolerability:] Duration of bleeding / spotting episodes by cycle and reference period., [Secondary safety and tolerability:] Clinical laboratory parameters (haematology, biochemistry including estradiol levels, TSH and urinalysis; in a subset of subjects: haemostatic variables, carbohydrate metabolism, bone mineral density biomarkers, SHBG)., [Secondary safety and tolerability:] IP acceptability., [Secondary safety and tolerability:] Quality of Life Enjoyment and Satisfaction Questionnaire - Short Form (Q-LES-Q-SF).

Source: https://euclinicaltrials.eu/ctis-public/view/2022-502024-51-00